EU clinical trial 2023-509429-37-00: A Phase III, Open-label, Randomised, Multicentre Study of Ceralasertib Plus Durvalumab Versus Docetaxel in Patients With Advanced or Metastatic Non-Small Cell Lung Cancer Without Actionable Genomic Alterations, and Whose Disease Has Progressed On or After Prior Anti-PD-(L)1 Therapy and Platinum-based Chemotherapy: LATIFY
Protocol code: D533BC00001
Sponsor: AstraZeneca AB (Pharmaceutical company). Phase: Therapeutic confirmatory (Phase III). Countries: Romania (ended), Netherlands (ended), Ireland (ongoing, recruitment ended), Italy (ended), France (ended), Germany (ended), Poland (ongoing, recruitment ended), Hungary (ended), Spain (ongoing, recruitment ended), Belgium (ended).
Therapeutic area(s): Diseases [C] - Neoplasms [C04]
Gender: Female, Male. Age: 18-64 years, 65+ years. Enrolment: 520.
Start date (EU): 2022-10-03. Decision date: 2024-01-31. Results received: No. Last updated: 2026-05-05.
Decision dates by country: BE: 2024-02-05, DE: 2024-02-02, IE: 2024-01-31, PL: 2024-02-02, IT: 2024-02-08, NL: 2024-01-31, HU: 2024-02-01, FR: 2024-01-31, RO: 2024-02-26, ES: 2024-02-26

Condition(s): Advanced or Metastatic Non-Small Cell Lung Cancer
Product: DOCETAXEL, Inflectra 100 mg powder for concentrate for solution for infusion, Mycofit, 250 mg, kapsułki twarde, DOCETAXEL, INFLIXIMAB, Remsima 100 mg powder for concentrate for solution for infusion, Ceralasertib, MYCOPHENOLATE MOFETIL, Docetaxel Hikma 80 mg/4 ml Konzentrat zur Herstellung einer Infusionslösung, DOCETAXEL, MYCOPHENOLATE MOFETIL, IMFINZI 50 mg/mL concentrate for solution for infusion.

Primary endpoint: OS is defined as time from randomisation until the date of death due to any cause. The comparison will include all randomised participants, regardless of whether the participant withdraws from randomised therapy or receives another anti-cancer therapy. The measure of interest is the HR of OS.
Endpoint(s): To demonstrate superiority of ceralasertib plus durvalumab relative to docetaxel by assessment of PFS, ORR, DoR, TTR, DCR at 18 weeks, PFS2, OS at 12 months (OS12), participant-reported health-related quality of life (QoL), participant- reported physical functioning, participant-reported treatment tolerability., To assess the PK of ceralasertib when administered in combination with durvalumab., To assess safety and tolerability of ceralasertib plus durvalumab therapy as compared with docetaxel

Source: https://euclinicaltrials.eu/ctis-public/view/2023-509429-37-00